EU clinical trial 2023-509898-23-00: DECISION; Digoxin Evaluation in Chronic heart failure: Investigational Study In Outpatients in the Netherlands
Sponsor: Universitair Medisch Centrum Groningen (Hospital/Clinic/Other health care facility). Phase: Therapeutic use (Phase IV). Countries: Netherlands (ended).
Therapeutic area(s): Diseases [C] - Cardiovascular Diseases [C14]
Gender: Female, Male. Age: 18-64 years, 65+ years. Enrolment: 982.
Status: Ended. Start date (EU): 2024-11-01. End date (EU): 2025-11-19. Decision date: 2024-10-18. Results received: No. Last updated: 2026-01-12.

Condition(s): heart failure
Product: DIGOXIN

Primary endpoint: The primary endpoint is the composite of (repeated) HF hospitalizations, (repeated) urgent HF hospital visits and cardiovascular death.
Endpoint(s): All-cause mortality, Cardiovascular death., (Repeated) HF hospitalization, (repeated) urgent HF hospital visits, Cost-effectiveness., All-cause hospitalizations., Unscheduled cardiovascular hospital visits., Days alive out of hospital., Quality of Life., Heart rate in both AF and sinus rhythm., To assess side effects (including SUSARs) associated with study medication., Initiation of (recurrence of) AF in patients with sinus rhythm at baseline., Conversion to sinus rhythm and maintenance of sinus rhythm in patients with AF at baseline, Proteomics and validating hits in elisa's

Source: https://euclinicaltrials.eu/ctis-public/view/2023-509898-23-00